EU clinical trial 2025-520747-32-00: A Phase 3, Randomized, Double-Blind, Placebo-Controlled, Parallel-Group Study to Evaluate the Efficacy and Safety of KarXT + KarX-EC for the Treatment of Cognitive Impairment Associated with Mild to Moderate Alzheimer’s Disease (MINDSET 2)
Protocol code: CN012-0052
Sponsor: Bristol-Myers Squibb Services Unlimited Company (Pharmaceutical company). Phase: Therapeutic confirmatory (Phase III). Countries: Germany (ongoing, recruiting), Netherlands (ongoing, recruiting), Portugal (ongoing, recruiting), France (ongoing, recruiting), Spain (ongoing, recruiting), Poland (ongoing, recruiting), Greece (ongoing, recruiting), Romania (ongoing, recruiting), Italy (authorised, recruiting), Finland (ongoing, recruiting).
Therapeutic area(s): Psychiatry and Psychology [F] - Mental Disorders [F03]
Gender: Female, Male. Age: 18-64 years, 65+ years. Enrolment: 292.
Start date (EU): 2025-10-29. Decision date: 2025-10-21. Results received: No. Last updated: 2026-07-29.
Decision dates by country: FI: 2025-10-21, NL: 2025-10-27, IT: 2025-10-23, DE: 2025-10-21, ES: 2025-10-23, GR: 2025-10-21, RO: 2025-10-27, PL: 2025-11-11, PT: 2025-10-21, FR: 2025-10-24

Condition(s): Mild to moderate Alzheimer’s Disease
Product: KarXT, KarXT, KarXT, KarX-EC, KarX-EC matching placebo, KarX-EC, KarXT, KarXT matching placebo, KarX-EC, KarX-EC

Primary endpoint: Change from baseline in ADAS-Cog11 at Week 24, CIBIC+ at Week 24
Endpoint(s): Change from baseline in ADCS-ADL at Week 24, Change from baseline in NPI-10 total score at Week 24, Occurence of AEs and SAEs, AESIs, AEs leading to study intervention discontinuation, AEs leading to study discontinuation, and AEs leading to death through Week 24, Incidence and severity of clinically significant changes in vital signs, ECG, C-SSRS, weight, and safety laboratory tests through Week 24

Source: https://euclinicaltrials.eu/ctis-public/view/2025-520747-32-00